EU clinical trial 2024-516756-18-00: Pharmacologically modulating the noradrenergic arousal system to reduce freezing of gait in Parkinson’s disease: a multi-center and multi-modal approach.
Protocol code: 116130
Sponsor: Stichting Radboud universitair medisch centrum (Hospital/Clinic/Other health care facility). Phase: Therapeutic confirmatory (Phase III). Countries: Netherlands (ongoing, recruiting).
Therapeutic area(s): Diseases [C] - Nervous System Diseases [C10]
Gender: Female, Male. Age: 18-64 years, 65+ years. Enrolment: 20.
Status: Ongoing, recruiting. Start date (EU): 2026-01-19. Decision date: 2025-06-30. Results received: No. Last updated: 2026-05-13.

Condition(s): Parkinson's disease
Product: Atomoxetine Aurobindo 40 mg hard capsules, Microcrystalline cellulose gelatin capsule

Primary endpoint: The effect of atomoxetine vs. placebo on the percentage of time frozen during FOG-provoking gait tasks in the dopaminergic OFF-state.
Endpoint(s): The effect of atomoxetine vs. placebo on the percentage of time frozen during FOG-provoking gait tasks in the dopaminergic ON-state., The effect of atomoxetine vs placebo on brain network topology, as calculated by the average integration/segregation coefficient.

Source: https://euclinicaltrials.eu/ctis-public/view/2024-516756-18-00